EU clinical trial 2024-517855-10-00: Morphine effects on stress response and social interaction – an exploratory randomized controlled experimental medicine study
Protocol code: MOR-STRESS-SI
Sponsor: Linkopings Universitet (Educational Institution). Phase: Therapeutic exploratory (Phase II). Countries: Sweden (ended).
Therapeutic area(s): Psychiatry and Psychology [F] - Behavior and Behavior Mechanisms [F01]; Psychiatry and Psychology [F] - Mental Disorders [F03]
Gender: Female, Male. Age: 18-64 years. Enrolment: 36.
Status: Ended. Start date (EU): 2022-04-20. End date (EU): 2025-07-08. Decision date: 2024-10-25. Results received: No. Last updated: 2024-10-25.

Condition(s): Healthy volunteers
Product: Morfin Abcur, 10 mg/ml, injektionsvätska, lösning, 0.9% Sodium Chloride Intravenous Infusion Solution

Primary endpoint: Subjective distress to exclusion (Visual analog scale)., Neural response to social exclusion (fMRI BOLD-signal).
Endpoint(s): Morphine effects on behavioral, psychophysiological, and neural responses to personal distance and social approach and avoidance within group., Rejection-induced distress effects on stress-related biomarkers (e.g., cortisol and endocannabinoid levels) and its interaction with morphine.

Source: https://euclinicaltrials.eu/ctis-public/view/2024-517855-10-00